EU clinical trial 2024-514748-10-00: Study to evaluate food effect on the pharmacokinetics of mesalazine oral formulation in healthy volunteers.
Protocol code: CGRA-0322/FOOD
Sponsor: Faes Farma S.A. (Pharmaceutical company). Phase: Human Pharmacology (Phase I)- Other. Countries: Spain (ended).
Therapeutic area(s): Diseases [C] - Digestive System Diseases [C06]
Gender: Female, Male. Age: 18-64 years. Enrolment: 34.
Status: Ended. Start date (EU): 2024-11-28. End date (EU): 2025-03-19. Decision date: 2024-10-18. Results received: No. Last updated: 2025-05-20.

Condition(s): Ulcerative colitis

Source: https://euclinicaltrials.eu/ctis-public/view/2024-514748-10-00